EU clinical trial 2023-509547-27-00: A Multicenter, Randomized, Double-Masked, Placebo-Controlled Phase 3 Study of the Efficacy, Safety, and Tolerability of Subcutaneously Administered Pozelimab in Combination with Cemdisiran or Cemdisiran Alone in Participants with Geographic Atrophy Secondary to Age-Related Macular Degeneration
Protocol code: R3918-AMD-2326
Sponsor: Regeneron Pharmaceuticals Inc. (Pharmaceutical company). Phase: Therapeutic confirmatory (Phase III). Countries: France (ongoing, recruiting), Austria (ongoing, recruiting), Spain (ongoing, recruiting), Poland (ongoing, recruiting), Italy (ongoing, recruiting), Germany (ongoing, recruiting), Hungary (ongoing, recruiting).
Therapeutic area(s): Diseases [C] - Eye Diseases [C11]
Gender: Female, Male. Age: 18-64 years, 65+ years. Enrolment: 464.
Status: Ongoing, recruiting. Start date (EU): 2025-05-22. Decision date: 2025-02-17. Results received: No. Last updated: 2026-06-12.
Decision dates by country: ES: 2025-02-17, IT: 2025-02-19, PL: 2025-07-09, AT: 2025-02-23, HU: 2025-02-19, DE: 2025-02-17, FR: 2025-06-25

Condition(s): Geographic Atrophy Secondary to Age-Related Macular Degeneration
Product: Placebo for pozelimab will be provided in an aqueous buffered solution and supplied by the sponsor., Placebo for cemdisiran is 0.9% saline and will be supplied by the sponsor., Pozelimab, Cemdisiran

Primary endpoint: Growth rate (slope) of total GA lesion area (mm^2 /year) measured by Fundus Autofluorescence (FAF)
Endpoint(s): Loss of Best Corrected Visual Acuity (BCVA) ≥15 Early Treatment Diabetic Retinopathy Study (ETDRS), Change in Low-contrast quantitative Visual Acuity (LC-qVA), Change in Low-Luminance Low-Contrast quantitative Visual Acuity (LL-LC-qVA), Change in quantitative Contrast Sensitivity Function (qCSF), Growth rate (slope) of total GA lesion area (mm^2 /year) measured by FAF, Concentrations of total pozelimab in serum, Concentrations of total cemdisiran in plasma, Change in concentration of total Complement component 5 (C5), Incidence of Antidrug antibody (ADA) to pozelimab, Magnitude of ADA to pozelimab, Incidence of ADA to cemdisiran, Magnitude of ADA to cemdisiran, Incidence of Neutralizing antibody (NAb) to pozelimab, Occurrence of Treatment-emergent adverse events (TEAEs), Severity of TEAEs

Source: https://euclinicaltrials.eu/ctis-public/view/2023-509547-27-00